EU clinical trial 2024-511677-29-01: Benefits of inhalation of 7% hypertonic saline solution prior to ELTGOL physiotherapy, in patients with bronchiectasis. A randomized controlled trial.
Protocol code: ELTGOL
Sponsor: Hospital Universitari De Girona Doctor Josep Trueta (Hospital/Clinic/Other health care facility). Phase: Therapeutic use (Phase IV). Countries: Spain (ongoing, recruiting).
Therapeutic area(s): Diseases [C] - Respiratory Tract Diseases [C08]
Gender: Female, Male. Age: 18-64 years, 65+ years. Enrolment: 57.
Status: Ongoing, recruiting. Start date (EU): 2024-06-20. Decision date: 2024-11-05. Results received: No. Last updated: 2025-07-11.

Condition(s): BRONCHIECTASIA
Product: ELECTROLYTES, SODIUM CHLORIDE

Primary endpoint: change in the sputum weight in grams during intervention from baseline to V7
Endpoint(s): Change from baseline in the 24h sputum volume in millilitres and sputum weight (defined as the sputum volume during the intervention and 24 hours later) over the 12-month treatment period., Change in cough assessed with the Leicester Cough Questionnaire26 from V2 over the 12-month treatment period, Number of exacerbations and the time to the first exacerbation over the 12-month treatment period, Change in sputum purulence assessed by the sputum colour chart, mucus properties, and microbiology from V2 to V7., Change in quality of life (assessed with Bronchiectasis health questionnaire and Saint George Respiratory questionnaire) from V2 over the 12-month treatment period, Change from V2 in post-bronchodilator FEV1 over the 12-month treatment period in ml, Treatment adherence assessed through vial counting, Morisky-Green test, the diary card., Adverse events assessed by symptoms reported, vital sign measurement (including blood pressure and arterial oxygen saturation), physical examination, Borg scale at the end of interventions at V2, V3, V5, V7, and pulmonary function tests at V2., Change from V7 to V8 in the 24h sputum volume, colour and weight, quality of life and FEV1

Source: https://euclinicaltrials.eu/ctis-public/view/2024-511677-29-01